EU clinical trial 2023-506170-12-00: A Patient- and Investigator-Blind, Placebo-Controlled Study to Evaluate the Efficacy, Safety, and Tolerability of Bepranemab (UCB0107) in Study Participants With Prodromal to Mild Alzheimer’s Disease (AD), Followed by an Open-Label Extension Period
Protocol code: AH0003
Sponsor: UCB Biopharma (Pharmaceutical company). Phase: Therapeutic exploratory (Phase II). Countries: Italy (ended), Spain (ended), Germany (ended), Poland (ended), Netherlands (ended), Belgium (ended), France (ended).
Therapeutic area(s): Diseases [C] - Nervous System Diseases [C10]
Gender: Female, Male. Age: 18-64 years, 65+ years. Enrolment: 251.
Status: Ended. Start date (EU): 2021-10-18. End date (EU): 2025-08-01. End date: 2025-08-02. Decision date: 2024-02-07. Results received: Yes. Last updated: 2025-09-08.
Decision dates by country: BE: 2024-02-19, FR: 2024-02-12, DE: 2024-02-12, IT: 2024-03-21, ES: 2024-02-07, NL: 2024-02-07, PL: 2024-02-25

Condition(s): Alzheimer’s Disease
Product: Bepranemab, Placebo matching and without active substance, Neuraceq 300 MBq/mL solution for injection, (18F) GTP1

Primary endpoint: Change from Baseline to Week 80 in the Clinical Dementia Rating Scale Sum of Boxes (CDR-SB) total score
Endpoint(s): Incidence of treatment-emergent adverse events (TEAEs), Incidence of treatment-emergent serious adverse events (TESAEs), Incidence of TEAEs leading to discontinuation or death, Incidence of Drug-related TEAEs, Change from Baseline in suicidal ideation and behavior as assessed by the Columbia-Suicide Severity Rating Scale (C-SSRS), Change from Baseline to Week 56 and Week 80 on indices of tau burden in the brain as measured by [18F]Genentech tau probe 1 (GTP1) positron emission tomography (PET), Change from Baseline to Week 56 and Week 80 in Alzheimer's Disease Assessment Scale-Cognitive Subscale (ADAS-Cog14), Change from Baseline to Week 56 and Week 80 in Amsterdam-Instrumental Activities of Daily Living (AiADL), Change from Baseline to Week 56 and Week 80 in Mini-Mental State Examination (MMSE) total score, Serum concentrations of bepranemab over the 80- week Double-blind Treatment Period

Source: https://euclinicaltrials.eu/ctis-public/view/2023-506170-12-00